EU clinical trial 2024-514822-21-00: A Phase 3 Randomized, Open-label Study of Rinatabart Sesutecan (Rina-S) versus Treatment of Investigator’s Choice (IC) in Patients with Platinum Resistant Ovarian Cancer
Protocol code: GCT1184-02
Sponsor: Genmab A/S (Pharmaceutical company). Phase: Therapeutic confirmatory (Phase III). Countries: Spain (ongoing, recruiting), Norway (ongoing, recruiting), Czechia (ongoing, recruiting), Netherlands (ongoing, recruiting), Germany (authorised, recruiting), Belgium (ongoing, recruiting), Italy (ongoing, recruiting), Poland (authorised, recruiting), France (ongoing, recruiting), Greece (ongoing, recruiting), Denmark (authorised, recruiting), Austria (authorised, recruiting).
Therapeutic area(s): Diseases [C] - Neoplasms [C04]
Gender: Female. Age: 18-64 years, 65+ years. Enrolment: 171.
Start date (EU): 2025-10-02. Decision date: 2025-05-20. Results received: No. Last updated: 2026-03-13.
Decision dates by country: BE: 2025-05-21, CZ: 2025-05-20, IT: 2025-05-23, GR: 2025-05-20, NO: 2025-05-20, DK: 2025-05-20, NL: 2025-05-26, DE: 2025-05-23, PL: 2025-05-25, AT: 2025-05-26, ES: 2025-05-20, FR: 2025-05-26

Condition(s): Platinum-resistant Ovarian Cancer
Product: PEGFILGRASTIM, PACLITAXEL, DOXORUBICIN, Rinatabart Sesutecan, GEMCITABINE, TOPOTECAN

Primary endpoint: Progression-Free Survival (PFS) PFS is defined as the time from the date of randomization to the date of the first documented progression or death (PD) due to any cause, whichever occurs first based on response evaluation criteria in solid tumors (RECIST) version 1.1 as assessed by the investigator.
Endpoint(s): 1. Overall Survival (OS) OS is defined as the time from date of randomization to date of death due to any cause., 2. Objective Response Rate (ORR) ORR is defined as the percentage of participants with best overall response (BOR) of complete response (CR) or partial response (PR) based on RECIST v1.1 as assessed by the investigator., 4. Duration of Response (DOR) DOR is defined as the time from the onset date of response to the date of the first documented progression or death due to any cause based on RECIST v1.1 as assessed by the investigator and BICR., 5. Percentage of Participants Who Achieved Cancer Antigen-125 (CA-125) Response per Gynecologic Cancer Intergroup (GCIG) Criteria A CA-125 response per the GCIG criteria is defined as a ≥ 50% reduction in CA-125 levels from baseline., 6. Time to Second Disease Progression or Death From any Cause (PFS2) PFS2 is defined as the time from randomization to the date of the second PD (i.e., the first PD reported in subsequent anti-cancer therapies, or long-term follow up) or death., 9. Overall Change From Baseline in Global Health Status/Quality of Life (GHS/Qol) Overall change from baseline in GHS/Qol score (items 29 and 30) will be calculated using the European Organization for Research and Treatment of Cancer Quality of Life Core 30 (EORTC-QLQ-C30) questionnaire. The score ranges from 0 to 100. A high scale score represents a higher response level., 10. Time to Deterioration (TTD) in the GHS/Qol Score TTD in the GHS/Qol score is defined as the time from baseline to the first onset of a ≥10-point negative change (decrease) in GHS/QoL score. A longer TTD indicates a better outcome., 7. Number of Participants With Treatment-emergent Adverse Events (TEAEs) and Laboratory Abnormalities, 8. Change From Baseline in Electrocardiogram (ECG) Findings to Assess Changes in QTc Associated with Rina-S by Holter Monitor, 3. Progression Free Survival (PFS) and ORR, per RECIST v1.1, as determined by blinded independent central review (BICR)

Source: https://euclinicaltrials.eu/ctis-public/view/2024-514822-21-00